EU clinical trial 2023-509305-68-00: A Study Evaluating the Long-term Efficacy and Safety of Ralinepag in Subjects with PAH via an Open-label Extension (ADVANCE-Extension)
Protocol code: ROR-PH-303
Sponsor: United Therapeutics Corp. (Pharmaceutical company). Phase: Therapeutic confirmatory (Phase III). Countries: Netherlands (ongoing, recruitment ended), Spain (ongoing, recruitment ended), Hungary (ongoing, recruitment ended), Bulgaria (ongoing, recruitment ended), Greece (ongoing, recruitment ended), France (ongoing, recruitment ended), Austria (ongoing, recruitment ended), Belgium (ongoing, recruitment ended), Italy (ongoing, recruitment ended), Germany (ongoing, recruitment ended), Poland (ongoing, recruitment ended), Romania (ongoing, recruitment ended), Czechia (ongoing, recruitment ended), Portugal (ongoing, recruitment ended), Denmark (ongoing, recruitment ended).
Therapeutic area(s): Diseases [C] - Cardiovascular Diseases [C14]
Gender: Female, Male. Age: 18-64 years, 65+ years. Enrolment: 156.
Status: Ongoing, recruitment ended. Start date (EU): 2019-05-16. Decision date: 2024-06-19. Results received: No. Last updated: 2026-01-15.
Decision dates by country: ES: 2024-06-20, BG: 2024-07-02, NL: 2024-06-19, FR: 2024-06-24, PL: 2024-07-22, IT: 2024-06-24, CZ: 2024-06-20, RO: 2024-06-25, HU: 2024-06-19, DE: 2024-06-20, PT: 2024-07-02, GR: 2024-07-22, DK: 2024-06-19, AT: 2024-06-24, BE: 2024-06-21

Condition(s): Pulmonary arterial hypertension (PAH)
Product: Ralinepag, Ralinepag, Ralinepag, Ralinepag

Primary endpoint: Efficacy assessments will include an evaluation of: • NT-proBNP • 6MWD • WHO/NYHA FC • The proportion of subjects who achieve all 3 of the following (at specified time points): o NT-proBNP level <300 pg/mL o 6MWD >440 meters o WHO/NYHA FC II status or better • HRQoL measures (where validated) • Time to all-cause hospitalization during the study period • Time to all-cause mortality during the study period

Source: https://euclinicaltrials.eu/ctis-public/view/2023-509305-68-00